EU clinical trial 2023-509071-16-00: Renal Outcomes in the early use of vasopressin in the treatment of septic shock
Protocol code: EVSS
Sponsor: Azienda Unita Sanitaria Locale Di Bologna (Hospital/Clinic/Other health care facility). Phase: Therapeutic use (Phase IV). Countries: Italy (ongoing, recruiting).
Therapeutic area(s): Diseases [C] - Virus Diseases [C02]; Analytical, Diagnostic and Therapeutic Techniques and Equipment [E] - Therapeutics [E02]; Diseases [C] - Bacterial Infections and Mycoses [C01]
Gender: Female, Male. Age: 18-64 years, 65+ years. Enrolment: 242.
Status: Ongoing, recruiting. Start date (EU): 2024-05-22. Decision date: 2024-03-20. Results received: No. Last updated: 2026-04-20.

Condition(s): Septic shock
Product: Empressin 40 I.U./2 ml concentrato per soluzione per infusione, Empressin 40 I.U./2 ml concentrato per soluzione per infusione, SonoVue 8 microlitres/mL powder and solvent for dispersion for injection

Primary endpoint: 30% reduction of patients satisfying the criteria for CRRT within the study group.
Endpoint(s): Reduction of maximum KDIGO class reached in the first 7 days of hospitalization, Evaluation of renal perfusion using the CEUS method carried out within 24 hours of enrollment and 72 hours after the first evaluation (in terms of the presence of ischemic areas, their number and size, Water balance 24, 48, 72 hours after admission to the ICU, Number of patients meeting criteria for RRT during ICU stay, Number of patients who develop AF, atrial flutter or PSVT lasting more than 30 minutes and who require the introduction of new drugs for rate or rhythm control or electrical cardioversion within 24 hours of arrhythmic onset, Number of patients who present intestinal ischemia or extremity ischemia during the infusion of vasoactive drugs or within 3 days after the end of the administration of the aforementioned drugs, Length of stay in ICU and mortality at 28 and 90 days

Source: https://euclinicaltrials.eu/ctis-public/view/2023-509071-16-00